EU clinical trial 2025-524978-42-00: Multicentre study evaluating the efficacy of a 7-day course of doxycycline for the treatment of asymptomatic anal lymphogranuloma venereum SHORT-LGV
Sponsor: Centre Hospitalier Universitaire De Bordeaux (Hospital/Clinic/Other health care facility). Phase: Therapeutic exploratory (Phase II). Countries: France (authorised, recruitment pending).
Therapeutic area(s): Diseases [C] - Bacterial Infections and Mycoses [C01]
Gender: Male. Age: 18-64 years, 65+ years. Enrolment: 120.
Status: Authorised, recruitment pending. Decision date: 2026-05-18. Results received: No. Last updated: 2026-05-20.
Decision dates by country: FR: 2026-05-20

Condition(s): Asymptomatic anal LGV infection
Product: DOXYCYCLINE SANDOZ 100 mg, comprimé sécable

Primary endpoint: The microbiological cure is defined as a LGV-negative NAAT result in anal specimen four weeks after treatment initiation among participants with a LGV-positive NAAT result at baseline.
Endpoint(s): The distribution of the C. trachomatis genotypes in LGV-positive anal specimens collected at baseline will be studied by sequencing the ompA gene (defining the ompA-genotype) in each specimen, Treatment failure defined as i/identical ompA-genotype in the anal swabs collected at baseline and at four weeks after treatment initiation or ii/ the ompA genotype could not be determined, individuals reporting either no anal sexual intercourse after treatment or consistent condom use between inclusion and visit at week 4, Reinfection defined as i/ different ompA-genotype in the anal swabs collected at baseline and at four weeks after treatment initiation or ii/ the ompA genotype could not be determined, individuals reporting unprotected anal sexual intercourse with an untreated or a new sexual partner between inclusion and visit at week 4, The C. trachomatis load will be studied at baseline and four weeks after treatment initiation using a quantitative real-time PCR and will be reported as the number of DNA copies per microliter, Molecular mechanisms for doxycycline resistance will be studied by sequencing the target genes in all LGV-positive specimens at baseline and four weeks after treatment initiation, Adherence to doxycycline will be evaluated using a diary, Adverse events (AE) and serious adverse events (SAE) recorded in the e-CRF

Source: https://euclinicaltrials.eu/ctis-public/view/2025-524978-42-00